EU clinical trial 2024-513549-36-01: A study to test how well different doses of BI 3804379 are tolerated by healthy people and patients with MASH
Protocol code: 1524-0001
Sponsor: Boehringer Ingelheim International GmbH (Industry). Phase: Human Pharmacology (Phase I)- First administration to humans. Countries: Belgium (ongoing, recruiting).
Therapeutic area(s): Not possible to specify
Gender: Female, Male. Age: 18-64 years, 65+ years. Enrolment: 124.
Status: Ongoing, recruiting. Start date (EU): 2024-09-10. Decision date: 2024-09-02. Results received: No. Last updated: 2026-05-13.

Condition(s): Metabolic Dysfunction-associated Steatohepatitis

Source: https://euclinicaltrials.eu/ctis-public/view/2024-513549-36-01